EU clinical trial 2025-524343-13-00: Pilot study of the efficacy of nicotinamide (vitamin B3) in Leber's hereditary optic neuropathy - NICOLHON
Protocol code: 49RC25_0169
Sponsor: Centre Hospitalier Universitaire D'Angers (Hospital/Clinic/Other health care facility). Phase: Therapeutic exploratory (Phase II). Countries: France (authorised, recruitment pending).
Therapeutic area(s): Diseases [C] - Eye Diseases [C11]; Diseases [C] - Nervous System Diseases [C10]
Gender: Female, Male. Age: 0-17 years, 18-64 years, 65+ years. Enrolment: 13.
Status: Authorised, recruitment pending. Decision date: 2026-03-03. Results received: No. Last updated: 2026-04-09.

Condition(s): Leber's Hereditary Optic Neuropathy
Product: NICOBION 500 mg, comprimé pelliculé

Primary endpoint: The primary endpoint will be the change in corrected distance visual acuity measured eye by eye using the ETDRS (Early Treatment Diabetic Retinopathy Study) scale over the entire follow-up period (inclusion, 3, 6, 9, and 12 months).
Endpoint(s): corrected distance visual acuity measured eye by eye at 12 months using the ETDRS scale, taking the nadir (lowest visual acuity reached a few weeks after the onset of NOHL) as the reference value, corrected distance visual acuity measured eye by eye on a Monoyer scale, corrected near visual acuity measured eye by eye on a Parinaud scale, campimetric deficits based on the average and corrected average deviation measured in STAT 30 on an automated visual field, the appearance of the Goldman-type manual visual field, changes in the thickness of the retinal nerve fiber layer (RNFL) and the thickness of the retinal ganglion cell complex (GCC) measured by OCT (Optical Coherence Tomography), Patients' quality of life assessed using the NEI VFQ 25 questionnaire, The biological efficacy of the treatment assessed by the evolution of nicotinamide in patients' blood at 3 and 12 months, Hepatic toxicity assessed by transaminase levels, Optical coherence tomography (OCT) changes in the macula

Source: https://euclinicaltrials.eu/ctis-public/view/2025-524343-13-00